EU clinical trial 2024-513005-31-00: AMBRE : Open-label, randomized, multicenter, phase III study, comparing standard chemotherapy to standard combination of endocrine therapy with Abemaciclib as initial Metastatic treatment among patients with visceral metastasis of ER+ HER2- BREast cancer, high burden disease.
Protocol code: UC-0140/1901
Sponsor: Unicancer (Hospital/Clinic/Other health care facility). Phase: Therapeutic confirmatory (Phase III). Countries: France (ongoing, recruitment ended).
Therapeutic area(s): Diseases [C] - Neoplasms [C04]
Gender: Female. Age: 18-64 years, 65+ years. Enrolment: 180.
Status: Ongoing, recruitment ended. Start date (EU): 2020-06-11. Decision date: 2024-10-01. Results received: No. Last updated: 2026-02-04.

Condition(s): Patients with untreated metastatic Estrogen Receptor positive (ER+), Human Epidermal Growth Factor Receptor-2 negative (HER2-) breast cancer with visceral involvement
Product: LETROZOLE, ANASTROZOLE, CAPECITABINE, PACLITAXEL, CAPECITABINE, Verzenios 50 mg film-coated tablets, FULVESTRANT

Primary endpoint: Progression-free survival (PFS) will be measured from the date of randomization until the date of event defined as the first documented progression (RECIST v1.1) or death from any cause. Patients with no event at the time of the analysis will be censored at the date of the last available tumor assessment or last follow-up visit whichever comes first. The patients free of progression who switched to another therapy will be censored at the time of the treatment change (RECIST v1.1)
Endpoint(s): In both arms throughout treatments A focus will be done at 24 weeks: the progression-free survival (PFS) within 24 weeks will be estimated from the date of randomization until the date of event defined as the first documented progression (RECIST v1.1) or death from any cause, In both arms throughout treatments EORTC QLQ-C30 and QLQ-BR23 questionnaires will be used in the measurement of patients’ quality of life. All dimensions will be available at baseline and every 6 weeks during 24 weeks. G8 questionnaire will also be requested at baseline for patient older than 70, In both arms throughout treatments Radiological response rates in each treatment arm will be determined according to RECIST v1.1: The overall response rate (ORR) will be defined as the proportion of randomized patients who achieve a complete response (CR) or a partial response (PR) at 24 weeks, In both arms throughout treatments Radiological response rates in each treatment arm will be determined according to RECIST v1.1: The duration of response (DoR) will be defined as the duration between the time of tumor response (CR or PR) until the date of objective progression, In both arms throughout treatments PFS1: Defined as the interval between the date of randomization and the date of progression or death from any cause regardless of whether the patient withdraws from randomized study treatment or receives another anti-cancer therapy prior to progression, In both arms throughout treatments PFS2 : Time from randomization to second progression is defined as the time from the date of randomization to the earliest of the progression event subsequent to that used for the primary variable PFS, or date of death (i.e., objective radiological, CA15-3 or symptomatic progression), In both arms throughout treatments PFS1 and PFS2 in subgroups defined by stratification factors, In both arms throughout treatments Overall survival (OS) is defined as the interval between the date of randomization and the date of death from any cause, In both arms throughout treatments Safety will be evaluated according to the CTCAE V5.0, In patients randomized in Chemotherapy arm: Type of maintenance regimens administered after the end of the standard treatment by chemotherapy and in the absence of disease progression, Serial CTC counts will be performed using the CellSearch® system on blood samples to assess predictive and prognostic value of CTC status on overall response rate, PFS within 24 weeks, PFS1 and PFS2 respectively

Source: https://euclinicaltrials.eu/ctis-public/view/2024-513005-31-00